EU clinical trial 2023-503705-10-00: Patient- and care-related benefits of amyloid PET imaging (ENABLE)
Protocol code: PETAD01
Sponsor: Deutsches Zentrum Fuer Neurodegenerative Erkrankungen e.V. (Laboratory/Research/Testing facility). Phase: Therapeutic use (Phase IV). Countries: Germany (ongoing, recruiting).
Therapeutic area(s): Psychiatry and Psychology [F] - Mental Disorders [F03]
Gender: Female, Male. Age: 18-64 years, 65+ years. Enrolment: 1126.
Status: Ongoing, recruiting. Start date (EU): 2024-08-19. Decision date: 2023-10-24. Results received: No. Last updated: 2026-07-17.

Condition(s): Dementia in human immunodeficiency virus [HIV] disease, Multi-infarct dementia, Unspecified dementia, Dementia in Alzheimer disease, unspecified, Dementia in Alzheimer disease with late onset, Dementia in Parkinson disease, Other vascular dementia, Dementia in Creutzfeldt-Jakob disease, Subcortical vascular dementia, Dementia in Huntington disease, Dementia in Alzheimer disease, atypical or mixed type, Dementia in Alzheimer disease with early onset, Vascular dementia of acute onset, Dementia in other specified diseases classified elsewhere, Dementia in Pick disease, Vascular dementia, unspecified, Mixed cortical and subcortical vascular dementia
Product: VIZAMYL 400 MBq/mL solution for injection, Neuraceq 300 MBq/mL solution for injection

Primary endpoint: Measured by investigators blinded to the intervention condition: Ability to manage activities of daily living as measured by the Amsterdam Instrumental Activities of Daily Living Questionnaire© (A-IADL-Q) score 78 weeks after randomization.
Endpoint(s): Measured by the specialist at the PET centre: occurrence of adverse events in the amyloid PET arm during and immediately after the performance of the amyloid PET examination; measured by the investigator at the trial site in the amyloid PET and control arms over the entire period of the trial: Incidence of adverse and serious adverse events (SAEs) including adverse drug reactions (ARs), mortality (also in the context of the safety assessment), Measured via the investigator at the trial site (26 weeks after randomisation): Change in aetiological diagnosis of dementia (additional 78 weeks after randomization), change in diagnostic certainty, change in diagnostic and therapeutic (especially administration or discontinuation of medication) management., Measured across patients and/or relatives by investigators blinded to examination condition (26, 52, 78 and 104 weeks after randomisation): Cognitive performance (ADAS-cog, MMSE), quality of life, incl. health-related quality of life (QOL-AD scale), Measured across patients and/or relatives by investigators blinded to examination condition (26, 52, 78 and 104 weeks after randomisation): need for full inpatient or institutionalised outpatient care (institutionalisation) or intensification of institutionalised outpatient care as well as total duration and frequency of unplanned inpatient stays within one year (FIMA)., Measured across patients and/or relatives by investigators blinded to examination condition (78 weeks after randomization): CDR(clinical severity rating of dementia) and GDS(Geriatric Depression Scale), Measured by an independent doctor after database closure: Use of potentially unsuitable medication (PRISCUS list)

Source: https://euclinicaltrials.eu/ctis-public/view/2023-503705-10-00